EU clinical trial 2025-521880-10-00: TulmiSTAR-01: A two-part, Phase I dose escalation and expansion followed by a randomized, open-label multicenter, Phase II study to assess the safety and efficacy of the combination of tulmimetostat (DZR123) and JSB462 (luxdegalutamide) vs standard of care in patients with progressive metastatic castrate resistant prostate cancer
Protocol code: CDZR123A12107
Sponsor: Novartis Pharma AG (Pharmaceutical company). Phase: Phase I and Phase II (Integrated)- Other. Countries: Italy (ongoing, recruiting), Germany (authorised, recruitment pending), Poland (ongoing, recruiting), France (ongoing, recruiting), Denmark (ongoing, recruiting), Spain (ongoing, recruiting).
Therapeutic area(s): Diseases [C] - Neoplasms [C04]
Gender: Male. Age: 18-64 years, 65+ years. Enrolment: 76.
Start date (EU): 2026-02-16. Decision date: 2025-12-01. Results received: No. Last updated: 2026-04-07.
Decision dates by country: DK: 2025-12-01, FR: 2025-12-03, DE: 2025-12-04, IT: 2025-12-03, ES: 2025-12-09, PL: 2025-12-08

Condition(s): Metastatic castrate resistant prostate cancer (mCRPC)
Product: Luxdegalutamide, DZR123, DOCETAXEL, CABAZITAXEL, ABIRATERONE, DZR123, ENZALUTAMIDE

Primary endpoint: • Part 1a: Dose-limiting toxicities (DLTs) • Part 1a and Part 1b: Safety: Type, frequency and severity of AEs per Common Terminology Criteria for Adverse Events (CTCAE) version 5.0, and notable values in laboratory, vital signs, and electrocardiogram (ECGs). Tolerability: Dose interruptions, dose reductions, drug discontinuations, dose intensity, and duration of exposure to each study drug, Part 1b and Part 2: PSA50 at Month 6, defined as the PSA reduction of at least 50% from baseline at 6 months confirmed by a second PSA measurement ≥ 3 weeks later.
Endpoint(s): Plasma concentrations of tulmimetostat and JSB462 (Phase I and Phase II), and derived PK parameters including AUC and Cmax (Phase I only), Radiographic progression free survival (rPFS) defined as time between randomization and the first occurrence of disease progression as per PCWG3-modified RECIST v1.1 or death due to any cause;, Overall survival (OS) is defined as the time between randomization to date of death due to any cause, Objective response (OR) is defined as a confirmed complete response (CR) or partial response (PR) per PCWG3-modified RECIST 1.1 as assessed by the investigator, Best overall response (BOR) is defined as the best response per Prostate Cancer Working Group 3 (PCWG3)-modified RECIST 1.1 as assessed by the Investigator, Duration of response (DOR) is defined as time between first documented CR/PR and disease progression or death due to any cause per PCWG3-modified RECIST 1.1 as assessed by the investigator, Part 1b and Part 2: Time to first symptomatic skeletal event (TTSSE ) defined as time from randomization to the first new symptomatic pathological bone fracture, spinal cord compression, tumor-related orthopedic surgical intervention, requirement for radiation therapy to relieve bone pain or death from any cause, whichever occurs first., Safety: Type, frequency and severity of adverse events (AEs) per Common Terminology Criteria for Adverse Events (CTCAE) version 5.0, and notable values in laboratory, vital signs, and ECGs., Tolerability: Dose interruptions, dose reductions, drug discontinuations, dose intensity, and duration of exposure to each study drug, PSA50 at 3, 9 and 12 months, radiographic progression free survival (rPFS), overall survival (OS), objective response (OR), best overall response (BOR) and duration of response (DOR)

Source: https://euclinicaltrials.eu/ctis-public/view/2025-521880-10-00